EU clinical trial 2024-511636-27-00: Shortened vs standard chemotherapy combined with immunotherapy for the initial treatment of patients with high tumor burden Follicular Lymphoma A randomized, open label, phase III study by Fondazione Italiana Linfomi.
Protocol code: FIL_FOLL19
Sponsor: Fondazione Italiana Linfomi Ets (Patient organisation/association). Phase: Therapeutic confirmatory (Phase III). Countries: Italy (ongoing, recruitment ended).
Therapeutic area(s): Diseases [C] - Hemic and Lymphatic Diseases [C15]
Gender: Female, Male. Age: 18-64 years, 65+ years. Enrolment: 602.
Status: Ongoing, recruitment ended. Start date (EU): 2021-12-01. Decision date: 2024-11-27. Results received: No. Last updated: 2026-06-05.

Condition(s): Follicular Lymphoma
Product: RITUXIMAB, CYCLOPHOSPHAMIDE, PREDNISONE, BENDAMUSTINE, DOXORUBICIN, DOXORUBICIN, PREDNISONE, RITUXIMAB, RITUXIMAB, BENDAMUSTINE, CYCLOPHOSPHAMIDE, VINCRISTINE, OBINUTUZUMAB, RITUXIMAB, VINCRISTINE, OBINUTUZUMAB

Primary endpoint: Progression-free survival (PFS).
Endpoint(s): Overall Survival (OS);, Event Free Survival (EFS), Response rate (overall [ORR] and complete [CRR], according to Cheson 2014);, Molecular response evaluated by polymerase chain reaction (PCR) assessment of Bcl2/IgH rearrangement;, Safety of the treatment according to the current version of the CTCAE, Quality of life evaluated through the Patient reported outcomes (PROs) by means of the FACT-Lym questionnaire

Source: https://euclinicaltrials.eu/ctis-public/view/2024-511636-27-00